EU clinical trial 2024-514037-38-00: An open-label, crossover trial in otherwise healthy volunteers with allergic rhinitis to evaluate the relative bioavailability and hemodynamic effects of OX640 nasal epinephrine powder to a marketed epinephrine intramuscular injection
Protocol code: OX640-002
Sponsor: Orexo AB (Pharmaceutical company). Phase: Human Pharmacology (Phase I)- Other. Countries: Sweden (ended).
Therapeutic area(s): Not possible to specify
Gender: Female, Male. Age: 18-64 years. Enrolment: 30.
Status: Ended. Start date (EU): 2024-10-01. End date (EU): 2024-12-12. Decision date: 2024-09-11. Results received: No. Last updated: 2024-09-11.

Condition(s): Anaphylaxis

Source: https://euclinicaltrials.eu/ctis-public/view/2024-514037-38-00